EU clinical trial 2024-513348-27-00: A Randomized, Active-Controlled, Double-Blind, Phase 3 Study to Compare Efficacy and Safety of CT-P55 with Cosentyx in Patients with Moderate to Severe Plaque Psoriasis
Protocol code: CT-P55 3.1
Sponsor: Celltrion Inc. (Pharmaceutical company). Phase: Therapeutic confirmatory (Phase III). Countries: Poland (ongoing, recruitment ended).
Therapeutic area(s): Diseases [C] - Skin and Connective Tissue Diseases [C17]
Gender: Female, Male. Age: 18-64 years, 65+ years. Enrolment: 153.
Status: Ongoing, recruitment ended. Start date (EU): 2025-05-09. Decision date: 2025-02-17. Results received: No. Last updated: 2026-08-06.

Condition(s): Plaque psoriasis
Product: Cosentyx 150 mg solution for injection in pre-filled syringe, CT-P55

Primary endpoint: Percent change from baseline in PASI score at Week 8

Source: https://euclinicaltrials.eu/ctis-public/view/2024-513348-27-00